EU clinical trial 2023-507240-37-00: KAN-101-03: A Phase 2a Double-Blind, Placebo-Controlled Study to Evaluate the Efficacy, Safety, and Tolerability of KAN-101 In Participants With Celiac Disease
Protocol code: KAN-101-03
Sponsor: Kanyos Bio Inc. (Pharmaceutical company). Phase: Therapeutic exploratory (Phase II). Countries: Finland (ended), Ireland (ended), Poland (ended), Germany (ended), Netherlands (ended).
Therapeutic area(s): Diseases [C] - Immune System Diseases [C20]
Gender: Female, Male. Age: 18-64 years, 65+ years. Enrolment: 26.
Status: Ended. Start date (EU): 2024-04-30. End date (EU): 2024-12-23. End date: 2025-01-13. Decision date: 2024-04-02. Results received: Yes. Last updated: 2024-07-15.
Decision dates by country: NL: 2024-04-04, PL: 2024-04-04, FI: 2024-04-25, DE: 2024-04-05, IE: 2024-04-05

Condition(s): celiac disease
Product: SODIUM CHLORIDE

Primary endpoint: Changes from baseline in Vh:Cd ratio as assessed by esophagogastroduodenoscopy (EGD) with biopsy after 2-week GC (at Day 29).
Endpoint(s): IL-2 change from Day 15 (first day of GC) pre GC to Day 15 post GC., Changes from baseline in IEL density in duodenum biopsy after 2-week GC (at Day 29)., •Incidence and severity of treatment emergent AEs as assessed by the Common Terminology Criteria for Adverse Events (CTCAE) v6.0 (or higher). •Incidence and titer of KAN-101 anti-drug antibodies (ADA)., Plasma concentration of KAN-101, and associated KAN-101 parameters: AUCinf, AUClast, Cmax, Tmax and t½.

Source: https://euclinicaltrials.eu/ctis-public/view/2023-507240-37-00